EU clinical trial 2024-517769-17-00: RAPAMALYMPH - Evaluation of the Efficacy of Rapamycin in the Treatment of Cervico-facial Lymphatic Malformations of Poor Prognosis
Protocol code: 2012_67
Sponsor: Centre Hospitalier Universitaire De Lille (Hospital/Clinic/Other health care facility). Phase: Therapeutic exploratory (Phase II). Countries: France (authorised, recruitment pending).
Therapeutic area(s): Diseases [C] - Otorhinolaryngologic Diseases [C09]
Gender: Female, Male. Age: 0-17 years, 18-64 years. Enrolment: 28.
Status: Authorised, recruitment pending. Decision date: 2024-11-21. Results received: No. Last updated: 2024-11-21.

Condition(s): Poor prognosis cervico-facial lymphatic malformations (Lymphangima)
Product: Rapamune 1 mg/mL oral solution

Primary endpoint: Assessment of the response in terms of lesion volume using volumetric MRI 3 months after the therapeutic plateau has been reached. A transient increase in lesion volume may be observed in the case of locoregional infections or direct trauma. In these situations, MRI may be delayed by one or two weeks to allow treatment of the intercurrent problem. A decrease in volume ≥ 1/5th will be considered a positive response.
Endpoint(s): The kinetics of the response are assessed by MRI at 6 months and 1 year, in order to evaluate the evolution at the end of treatment and at 6 months after stopping treatment., Known adverse reactions will be systematically investigated on a monthly basis., Clinical evaluation of the extent of the lesion, with photographic and video recording of the pharyngolaryngeal fibroscopy, with assessment of the infiltrated areas, the macroscopic appearance and the haemorrhagic appearance of the lesions., The scoring used the same scores as those used for the initial assessment, even if the patient changed age group during the study. This clinical assessment was carried out at 3 months, 6 months and 12 months. The assessment criterion is based on the change in scores between each examination., To evaluate the effectiveness of mTOR pathway inhibition, we will assess the impact of Rapamycin on signaling proteins (pAKT, p70S6 kinase, pMEK, pERK) in cellular samples before and after treatment using Bioplex, a method for analyzing phosphorylated proteins. We will also measure circulating angiogenic factors (VEGF C, VEGFR3) in serum samples before and after treatment using ELISA.

Source: https://euclinicaltrials.eu/ctis-public/view/2024-517769-17-00